EU clinical trial 2025-521357-17-00: To investigate the safety and efficacy of a novel investigational compound against neurological diseases such as Parkinson's disease in healthy men and women and patients with Parkinson's disease.
Protocol code: CHDR2441
Sponsor: Teitur Trophics ApS (Pharmaceutical company). Phase: Human Pharmacology (Phase I)- First administration to humans. Countries: Netherlands (ended).
Therapeutic area(s): Diseases [C] - Nervous System Diseases [C10]
Gender: Female, Male. Age: 18-64 years, 65+ years. Enrolment: 68.
Status: Ended. Start date (EU): 2025-06-13. End date (EU): 2026-05-29. Decision date: 2025-06-13. Results received: No. Last updated: 2026-03-11.
Decision dates by country: NL: 2025-07-02

Condition(s): Parkinson's disease

Source: https://euclinicaltrials.eu/ctis-public/view/2025-521357-17-00